EU clinical trial 2025-520503-27-00: A Phase 1, Randomized, Double-blind, Placebo-controlled Study Evaluating AMG 691 in Healthy Participants and Participants With Mild-to-Moderate Asthma
Protocol code: 20230151
Sponsor: Amgen Inc. (Pharmaceutical company). Phase: Human Pharmacology (Phase I)- First administration to humans. Countries: Belgium (ongoing, recruitment ended).
Therapeutic area(s): Diseases [C] - Respiratory Tract Diseases [C08]
Gender: Female, Male. Age: 18-64 years, 65+ years. Enrolment: 3.
Status: Ongoing, recruitment ended. Start date (EU): 2025-07-01. Decision date: 2025-05-27. Results received: No. Last updated: 2026-03-18.

Condition(s): Asthma

Source: https://euclinicaltrials.eu/ctis-public/view/2025-520503-27-00